EU clinical trial 2024-512719-28-00: A research study of how safe a new medicine called NNC0519‑0130 is and to test its effect in people living with excess body weight with or without type 2 diabetes
Protocol code: NN9541-8116
Sponsor: Novo Nordisk A/S (Pharmaceutical company). Phase: Human Pharmacology (Phase I)- Other. Countries: Germany (ended).
Therapeutic area(s): Diseases [C] - Nutritional and Metabolic Diseases [C18]
Gender: Female, Male. Age: 18-64 years. Enrolment: 64.
Status: Ended. Start date (EU): 2024-07-25. End date (EU): 2025-12-10. Decision date: 2024-07-22. Results received: No. Last updated: 2025-06-17.
Decision dates by country: DE: 2024-09-06

Condition(s): Obesity, Type 2 Diabetes with either overweight or obesity

Source: https://euclinicaltrials.eu/ctis-public/view/2024-512719-28-00